EU clinical trial 2022-501380-40-00: A Multicenter, Open-label, Phase 2 Dose Escalation and Confirmation, and Efficacy Expansion Study of Zilovertamab Vedotin (MK-2140) in Combination with R-CHP in Participants with DLBCL (waveLINE)
Protocol code: MK-2140-007
Sponsor: Merck Sharp & Dohme LLC (Pharmaceutical company). Phase: Therapeutic exploratory (Phase II). Countries: Spain (ongoing, recruitment ended), Poland (ongoing, recruitment ended), Italy (ongoing, recruitment ended).
Therapeutic area(s): Diseases [C] - Neoplasms [C04]
Gender: Female, Male. Age: 18-64 years, 65+ years. Enrolment: 27.
Status: Ongoing, recruitment ended. Start date (EU): 2022-08-10. Decision date: 2023-03-17. Results received: No. Last updated: 2026-05-28.
Decision dates by country: PL: 2023-04-04, ES: 2023-03-17, IT: 2023-04-03

Condition(s): Diffuse large B-cell lymphoma (DLBCL)
Product: PREDNISONE, RITUXIMAB, Zilovertamab vedotin, PREDNISONE, PREDNISOLONE, Truxima 500 mg concentrate for solution for infusion, DOXORUBICIN, CYCLOPHOSPHAMIDE, PREDNISOLONE

Primary endpoint: Number of Participants Who Experienced Dose-limiting Toxicities (DLTs) in Cycle 1, Number of Participants Who Experienced At Least One Adverse Event (AE), Number of Participants Who Discontinued Study Treatment Due to an Adverse Event (AE), Complete Response Rate (CRR) per Lugano Response Criteria
Endpoint(s): Objective Response Rate (ORR) per Lugano Response Criteria, Duration of Response (DOR) per Lugano Response Criteria

Source: https://euclinicaltrials.eu/ctis-public/view/2022-501380-40-00